EU clinical trial 2024-512403-39-01: A study to test a new immunotherapy, ABX-001, alone and in combination with the marketed drug, pembrolizumab, for the treatment of tumors previously treated with other therapies.
Protocol code: ABX-001-01
Sponsor: Abalos Therapeutics GmbH (Pharmaceutical company). Phase: Human Pharmacology (Phase I)- First administration to humans. Countries: Spain (ongoing, recruiting), Germany (ongoing, recruiting).
Therapeutic area(s): Diseases [C] - Neoplasms [C04]
Gender: Female, Male. Age: 18-64 years, 65+ years. Enrolment: 27.
Status: Ongoing, recruiting. Start date (EU): 2025-10-03. Decision date: 2025-09-22. Results received: No. Last updated: 2026-01-14.
Decision dates by country: DE: 2025-09-30, ES: 2025-09-22

Condition(s): Advanced Solid Tumors Who Are Beyond Standard of Care

Source: https://euclinicaltrials.eu/ctis-public/view/2024-512403-39-01